EU clinical trial 2023-504620-26-00: ETNA: Adjuvant pembrolizumab and chemotherapy or surveillance in Early Triple Negative breAst cancer with high stromal tumor-infiltrating lymphocytes (TILs) score
Protocol code: UC-BCG-2213
Sponsor: Unicancer, Institut Gustave Roussy (Hospital/Clinic/Other health care facility). Phase: Therapeutic exploratory (Phase II). Countries: Spain (ongoing, recruiting), France (ongoing, recruiting).
Therapeutic area(s): Diseases [C] - Neoplasms [C04]
Gender: Female, Male. Age: 18-64 years, 65+ years. Enrolment: 364.
Status: Ongoing, recruiting. Start date (EU): 2024-11-04. Decision date: 2024-05-30. Results received: No. Last updated: 2026-07-28.
Decision dates by country: FR: 2024-05-30, ES: 2024-05-31

Condition(s): Triple negative breast cancer
Product: PACLITAXEL, KEYTRUDA 25 mg/mL concentrate for solution for infusion

Primary endpoint: The primary endpoint is DDFS in cohort 1 and in cohort 2. DDFS is defined from the time from inclusion to the following events whichever comes first: distant recurrence of breast cancer, second primary non breast cancer, and death from any cause.
Endpoint(s): Efficacy - IDFS is defined from the time from inclusion to the following events whichever comes first : Ipsilateral invasive breast tumor recurrence; Regional invasive breast tumor recurrence; Distance recurrence; Death attributable to any cause, including breast cancer, non-breast cancer, or unknown cause; Second primary malignancy., Efficacy - DRFS is defined from the time from inclusion to the following events whichever comes first: distant recurrence of breast cancer, and death from any cause., Efficacy - OS is defined as the time from inclusion to date of death from any cause., Safety - Cohort 1: Safety and tolerability of pembrolizumab plus paclitaxel will be measured, every 3 weeks while on treatment and thereafter every 6 months for 5 years from study entry, Quality of life assessment - QoL domains will be assessed using: EORTC QLQ-C30, EORTC QLQ-B23, EORTC QLQ-FA12, and HADS – anxiety subscale., Exploratory endpoints - Comprehensive exploratory analysis will be performed on tumor tissue (initial biopsy, surgery and recurrence biopsy) and blood samples.

Source: https://euclinicaltrials.eu/ctis-public/view/2023-504620-26-00